EU clinical trial 2023-508583-30-00: Phase I-II Study to Assess the Safety, Tolerability and Efficacy of Lurbinectedin and Dostarlimab in Advanced/Recurrent Endometrial Cancer Patients with Disease Progression after Prior Therapy with Platinum-based Chemotherapy. LiDer trial
Sponsor: Vall D Hebron Institute Of Oncology (Laboratory/Research/Testing facility). Phase: Phase I and Phase II (Integrated)- Other. Countries: Spain (ended).
Therapeutic area(s): Diseases [C] - Neoplasms [C04]
Gender: Female. Age: 18-64 years, 65+ years. Enrolment: 58.
Status: Ended. End date (EU): 2024-10-25. Decision date: 2024-05-07. Results received: Yes. Last updated: 2024-09-25.

Condition(s): Advanced/Recurrent Endometrial Cancer Patients with Disease Progression after Prior Therapy with Platinum-based Chemotherapy
Product: lurbinectedin, JEMPERLI 500 mg concentrate for solution for infusion

Primary endpoint: Phase I Stage: Determination of MTD and RD: • The MTD will be the lowest dose level explored during dose escalation at which one third or more of evaluable patients experience a DLT during Cycle 1. • The RD will be the highest dose level explored during dose escalation at which less than one third of evaluable patients experience a DLT during Cycle 1., Phase II Stage: The primary objective of this stage is to assess the antitumor activity of the lurbinectedin and dostarlimab combination in terms of ORR, defined as the percentage of evaluable patients with a confirmed response, either complete (CR) or partial (PR).
Endpoint(s): • Safety: patients will be evaluable for safety if they have received at least one partial infusion of dostarlimab and lurbinectedin. AEs will be graded according to the NCI-CTCAE v.5 and coded using MedDRA dictionary version in force., • Efficacy: antitumor activity of the combination will be evaluated in terms of: Progression-free survival (PFS) Duration of response (DoR) Clinical benefit Overall survival (OS) Mid- and long-term survival, • Pharmacokinetics: PK parameters will be evaluated in plasma by standard non-compartmental and/or population methods., • Pharmacogenomics: the mutational status and the expression levels of potential predictive biomarkers of response and/or resistance to lurbinectedin and dostarlimab treatment will be analyzed from available tumor and blood samples obtained from all patients.

Source: https://euclinicaltrials.eu/ctis-public/view/2023-508583-30-00